EU clinical trial 2024-513276-17-00: An Open-label, Multicenter, Phase 1b Study of OV-1001 (Cusatuzumab; Anti-CD70 Monoclonal Antibody) in Combination with Background Therapy for the Treatment of Subjects with Acute Myeloid Leukemia
Protocol code: ELEV20235
Sponsor: OncoVerity Inc. (Pharmaceutical company). Phase: Human Pharmacology (Phase I)- Other. Countries: Germany (ongoing, recruitment ended).
Therapeutic area(s): Diseases [C] - Neoplasms [C04]
Gender: Female, Male. Age: 18-64 years, 65+ years. Enrolment: 10.
Status: Ongoing, recruitment ended. Start date (EU): 2020-07-01. Decision date: 2024-07-22. Results received: No. Last updated: 2026-07-15.

Condition(s): Acute Myeloid Leukemia

Source: https://euclinicaltrials.eu/ctis-public/view/2024-513276-17-00